EU clinical trial 2025-523526-40-00: C6461020 - An Interventional Open-Label Phase 1b/2 Study to Evaluate the Safety, Pharmacokinetics, and Preliminary Efficacy of PF-08634404 in combination with Different Anticancer Agents in Participants with Advanced Solid Tumors
Protocol code: C6461020
Sponsor: Pfizer Inc. (Pharmaceutical company). Phase: Phase I and Phase II (Integrated)- Other. Countries: Italy (authorised, recruitment pending), Spain (authorised, recruitment pending), France (authorised, recruitment pending), Germany (authorised, recruitment pending).
Therapeutic area(s): Diseases [C] - Neoplasms [C04]
Gender: Female, Male. Age: 18-64 years, 65+ years. Enrolment: 53.
Status: Authorised, recruitment pending. Decision date: 2026-04-09. Results received: No. Last updated: 2026-07-22.
Decision dates by country: FR: 2026-04-13, IT: 2026-04-09, DE: 2026-04-10, ES: 2026-04-10

Condition(s): Advanced Solid Tumors
Product: PF-08634404, Sigvotatug vedotin

Primary endpoint: Phase 1 Safety Run-In: AEs as characterized by type, frequency, severity (as graded by NCI CTCAE version 5.0), timing, seriousness, and relationship to study intervention., DLTs., Phase 2 Dose Optimization and Dose Expansion: Confirmed ORR per RECIST v1.1 by investigator, AEs as characterized by type, frequency, severity (as graded by NCI CTCAE version 5.0), timing, seriousness, and relationship to study intervention.
Endpoint(s): Phase 1 Safety Run-In: Confirmed ORR per RECIST v1.1 by investigator, DCR per RECIST v1.1 by investigator, DOR per RECIST v1.1 by investigator, PFS per RECIST v1.1 by investigator, OS, Laboratory abnormalities as characterized by type, frequency, severity (as graded by NCI CTCAE version 5.0), and timing., Predose and/or postdose concentrations of PF-08634404, SV, and PF-08046054., Incidence of ADA against PF-08634404, SV, and PF-08046054., Phase 2 Dose Optimization and Dose Expansion: DOR per RECIST v1.1 by investigator, DCR per RECIST v1.1 by investigator, PFS per RECIST v1.1 by investigator, OS, Laboratory abnormalities as characterized by type, frequency, severity (as graded by NCI CTCAE version 5.0), and timing., Predose and/or postdose concentrations of PF-08634404, SV, and PF-08046054., Incidence of ADA against PF-08634404, SV, and PF-08046054.

Source: https://euclinicaltrials.eu/ctis-public/view/2025-523526-40-00